EU clinical trial 2023-503474-20-00: Panguian
Sponsor: Rigshospitalet (Hospital/Clinic/Other health care facility). Phase: Phase III and phase IV (Integrated). Countries: Denmark (ongoing, recruiting).
Therapeutic area(s): Diseases [C] - Musculoskeletal Diseases [C05]
Gender: Female, Male. Age: 18-64 years, 65+ years. Enrolment: 100.
Status: Ongoing, recruiting. Start date (EU): 2017-11-10. Decision date: 2023-09-07. Results received: No. Last updated: 2023-09-07.

Condition(s): Rheumatoid arthritis

Source: https://euclinicaltrials.eu/ctis-public/view/2023-503474-20-00